EU clinical trial 2025-522383-33-00: A double blind, randomized, placebo-controlled exploratory trial to investigate the efficacy and safety of nerandomilast over 24 months when administered in individuals with interstitial lung abnormalities and a family history of pulmonary fibrosis to reduce the risk of worsening (DROP-FPF)
Protocol code: 1305-0069
Sponsor: Boehringer Ingelheim International GmbH (Pharmaceutical company). Phase: Therapeutic confirmatory (Phase III). Countries: Belgium (ongoing, recruiting), Spain (ongoing, recruiting), Netherlands (ongoing, recruiting), Italy (ongoing, recruiting), Germany (ongoing, recruiting), France (ongoing, recruiting).
Therapeutic area(s): Diseases [C] - Respiratory Tract Diseases [C08]
Gender: Female, Male. Age: 18-64 years, 65+ years. Enrolment: 28.
Status: Ongoing, recruiting. Start date (EU): 2026-03-23. Decision date: 2026-03-03. Results received: No. Last updated: 2026-07-01.
Decision dates by country: IT: 2026-03-03, NL: 2026-03-04, BE: 2026-03-04, ES: 2026-03-04, DE: 2026-03-04, FR: 2026-03-03

Condition(s): Pulmonary fibrosis, Interstitial lung diseases, Familial pulmonary fibrosis
Product: BI 1015550, BI 1015550, Placebo matching BI 1015550

Primary endpoint: Time to physiologic or radiologic worsening of ILA/ILD (defined as: relative decline in FVC % predicted of >10% from baseline; or absolute decline in DLCO % predicted >10% from baseline; or absolute increase in weighted reticulovascular score (wRVS) >2% and total disease extent (TDE) >2.5% on chest HRCT, as measured by e-Lung Quantitative HRCT scoring, from baseline) over the whole trial
Endpoint(s): Absolute change from baseline in wRVS on e-Lung Quantitative HRCT scoring at weeks 26, 52, and 104, Absolute change from baseline in TDE on e-Lung Quantitative HRCT scoring at weeks 26, 52, and 104, Absolute change from baseline in FVC (% predicted) at weeks 26, 52, and 104, Absolute change from baseline in DLCO (% predicted) at weeks 26, 52, and 104, Time to relative decline from baseline in FVC (% predicted) of >10% over 52 weeks and over the whole trial, Time to absolute decline from baseline in FVC (% predicted) of >5% over 52 weeks and over the whole trial, Time to absolute decline from baseline in DLCO (% predicted) of >10% over 52 weeks and over the whole trial, Time to absolute increase in wRVS >2% and TDE >2.5% on chest HRCT, as measured by e-Lung Quantitative HRCT scoring over 52 weeks and over the whole trial, Time to physiologic or radiologic worsening of ILA/ILD over 52 weeks

Source: https://euclinicaltrials.eu/ctis-public/view/2025-522383-33-00